EU clinical trial 2022-502707-29-00: Preeclampsia Intervention 4 – A double blind phase III randomised controlled trial assessing metformin to prolong gestation in preterm preeclampsia
Protocol code: PI4
Sponsor: Vastra Gotalandsregionen, University Of Gothenburg (Hospital/Clinic/Other health care facility, Educational Institution). Phase: Therapeutic confirmatory (Phase III). Countries: Sweden (ongoing, recruiting), Finland (ongoing, recruiting), Norway (ongoing, recruiting).
Therapeutic area(s): Diseases [C] - Female Urogenital Diseases and Pregnancy Complications [C13]
Gender: Female, Male. Age: 0-17 years, 18-64 years. Enrolment: 360.
Status: Ongoing, recruiting. Start date (EU): 2024-02-07. Decision date: 2023-05-31. Results received: No. Last updated: 2026-07-13.
Decision dates by country: NO: 2026-05-22, FI: 2026-03-04, SE: 2023-05-31

Condition(s): Preeclampsia
Product: Glucophage SR 500mg prolonged release tablet, Glucophage XR 500 mg RM Placebo

Primary endpoint: The primary endpoint is prolongation of gestation, defined as days and hours from randomisation to delivery. Prolongation of gestation in pregnancies with intrauterine fetal demise will be considered as interval censored between time from randomisation to last visit preceding delivery (where the baby was known to be alive) and time from randomisation to delivery.
Endpoint(s): Length of neonatal stay, defined as days and hours from birth to discharge from neonatal care, including both hospital and home-based care. Length of neonatal stay will be as zero if the infant was not admitted to neonatal care., Neonatal birthweight, in grams.

Source: https://euclinicaltrials.eu/ctis-public/view/2022-502707-29-00